EU clinical trial 2024-516631-27-00: Immune-Related Rheumatological and neurological Adverse Events study (IRRAE study)
Sponsor: Stichting Amsterdam UMC (Hospital/Clinic/Other health care facility). Phase: Therapeutic exploratory (Phase II). Countries: Netherlands (ongoing, recruiting).
Therapeutic area(s): Diseases [C] - Immune System Diseases [C20]; Analytical, Diagnostic and Therapeutic Techniques and Equipment [E] - Investigative Techniques [E05]; Diseases [C] - Neoplasms [C04]
Gender: Female, Male. Age: 18-64 years, 65+ years. Enrolment: 495.
Status: Ongoing, recruiting. Start date (EU): 2023-05-05. Decision date: 2024-12-03. Results received: No. Last updated: 2026-01-22.

Condition(s): Cancer (all types)
Product: KEYTRUDA 25 mg/mL concentrate for solution for infusion., OPDIVO 600 mg solution for injection, Fludeoxyglucose (18F)-Curium, 185 MBq/ml oplossing voor injectie., YERVOY 5 mg/ml concentrate for solution for infusion, Opdualag 240 mg/80 mg concentrate for solution for infusion

Primary endpoint: The differentiation and quantification of the (relative) frequency of different immune-cell subsets* in the peripheral blood (and potentially other biomaterials), The quantification of immune activity of the defined immune-cell subsets* by performing in vitro functional assays., The evaluation of the specific incidence, serological profiles and response to treatment of patients both with and without preexisting disease and starting ICI therapy and those developing irAE’s.
Endpoint(s): Disease activity and its progression over time were evaluated using disease-specific scoring metrics and the frequency, time of onset, duration, and severity (grade) of flares were recorded., The absolute change and fold-change in frequency of different immune-cell subsets* in the peripheral blood (and potentially other biomaterials) of R-irAE or N-irAE patients during immunosuppressive therapy., The immunohistochemical phenotype (determined in blood, synovial fluid and synovial tissue) of specifically R-irAE arthritis compared to classical RA., The qualitative comparison of whole body [18F]FDG PET/CT imaging of R-irAE arthritis patients with classical RA patients. The study endpoints are defined as: the standardized uptake value (SUV) metrics (SUVmax, SUVpeak and SUVmean) of the joints, muscles/muscle insertions and lymphoid organs and the biodistribution of the tracer - SUV metrics of certain organs at interest, such as the liver, spleen, bone marrow, heart, kidneys etc.

Source: https://euclinicaltrials.eu/ctis-public/view/2024-516631-27-00